EU clinical trial 2023-508416-35-00: A phase 4, randomised vaccination study in healthy adults to investigate the effects of acellular pertussis vaccine on colonisation with Bordetella pertussis using controlled human infection (KIM-study)
Protocol code: PaNaMa ID: 114794
Sponsor: Stichting Radboud University Medical Center (Hospital/Clinic/Other health care facility). Phase: Therapeutic use (Phase IV). Countries: Netherlands (ended).
Therapeutic area(s): Diseases [C] - Bacterial Infections and Mycoses [C01]
Gender: Female, Male. Age: 18-64 years. Enrolment: 99.
Status: Ended. Start date (EU): 2024-10-16. End date (EU): 2026-07-01. Decision date: 2024-06-04. Results received: No. Last updated: 2026-01-26.

Condition(s): Pertussis or 'whooping cough'
Product: Azitromycine 500 mg Teva, filmomhulde tabletten., REVAXIS Suspensie voor injectie in voorgevulde spuit. Difterie, tetanus en poliomyelitis (geïnactiveerd) vaccin, geadsorbeerd, beperkte hoeveelheid antigen(en)., REPEVAX, suspension for injection, in pre-filled syringe; Diphtheria, Tetanus, Pertussis (acellular, component) and Poliomyelitis (inactivated) Vaccine (adsorbed, reduced antigen(s) content)

Primary endpoint: Bp colonisation rate in Tdap-IPV and Td-IPV vaccination groups, with Bp colonisation defined as any positive Bp culture from nasal wash samples at any time point between Day 3 and Day 28 after challenge, Bp colonisation rate in Tdap-IPV vaccination groups, with Bp colonisation defined as any positive Bp culture from nasal wash samples at any time point between Day 3 and Day 28 after challenge

Source: https://euclinicaltrials.eu/ctis-public/view/2023-508416-35-00